EU clinical trial 2024-519024-25-00: Faecal Bacteriotherapy for Postantibiotic Diarrhoea in Critically Ill Patients – Randomised Controlled Trial
Protocol code: FEBATRIC
Sponsor: Fakultni Nemocnice Kralovske Vinohrady (Hospital/Clinic/Other health care facility). Phase: Therapeutic exploratory (Phase II). Countries: Czechia (authorised, recruitment pending).
Therapeutic area(s): Phenomena and Processes [G] - Digestive System and Oral Physiological Phenomena [G10]
Gender: Female, Male. Age: 18-64 years, 65+ years. Enrolment: 36.
Status: Authorised, recruitment pending. Decision date: 2024-12-03. Results received: No. Last updated: 2026-07-14.

Condition(s): Postantibiotic diarrhoea in critically ill patients
Product: HUMAN FAECAL TRANSPLANT purified from allogeneic faecal donations

Primary endpoint: Percentage of patients with treatment failure at day 7 after randomisation.
Endpoint(s): Composite number of adverse events such as new-onset sepsis, toxic mega-colon, positive post FBT blood culture, or other SAE assessed by the physi-cian-in-charge as possibly related to FBT., SOFA score at days 4 and 7., Percentage of patients that are recurrence-free at time of hospital discharge or day 28, whichever occur earlier., Subgroup analysis will be performed for patients who are C. dif. positive vs. negative and those who will receive antibiotics for a new extraabdominal in-fection vs. those who do not.

Source: https://euclinicaltrials.eu/ctis-public/view/2024-519024-25-00